EU clinical trial 2024-516294-78-00: A Single-Arm, Open-Label Pharmacokinetic, Safety, and Efficacy Study of ASTX727 in Combination with Venetoclax in Adult Patients with Acute Myeloid Leukemia
Protocol code: ASTX727-07
Sponsor: Taiho Oncology Inc. (Pharmaceutical company). Phase: Therapeutic exploratory (Phase II). Countries: Spain (ongoing, recruitment ended).
Therapeutic area(s): Diseases [C] - Neoplasms [C04]
Gender: Female, Male. Age: 18-64 years, 65+ years. Enrolment: 40.
Status: Ongoing, recruitment ended. Start date (EU): 2022-06-17. Decision date: 2024-08-14. Results received: No. Last updated: 2026-03-05.

Condition(s): Acute Myeloid Leukemia (AML)
Product: ASTX727, Venclyxto 50 mg film-coated tablets, Venclyxto 10 mg film-coated tablets, Venclyxto 100 mg film-coated tablets

Primary endpoint: Ph.1 Venetoclax AUC0-24 and Cmax on Day 5 with ASTX727 and Day 15 without ASTX727 in Cycle 2, Phase 2 Part A and B: CR rate, Phase 2 Part A: Venetoclax AUC0-24 and Cmax on Day 5 with ASTX727 and Day 15 without ASTX727 in Cycle 2.
Endpoint(s): Phase I: Decitabine and cedazuridine AUC0-24 and Cmax on Day 5 with venetoclax and cedazuridine AUC0-8 and on Day 5 with venetoclax in Cycle 2., Phase I, Phase II Part A and B: Incidence and severity of adverse events (AEs) as well as other safety assessments., Phase I, Phase II Part A and B: • CR rate • CR+CRh rate • CR+CRi rate, Phase I, Phase II Part A and B: • Time to CR or CRh • Duration of CR or CRh • Overall survival, Phase I: • 5-day cumulative decitabine AUC in Cycle 2. • Decitabine AUC0-24 and Cmax on Days 1 and 2 in Cycle 2 • Cedazuridine AUC0-8 on Days 1, 2, and 5 in Cycle 2; AUC0-24, AUC0-inf, and Cmax on Days 1, 2, and 5 in Cycle 2. • Cmax, Cmin, Tmax, T1/2 and other secondary PK parameters., Phase II, Part A and B: Decitabine and cedazuridine AUC0-24, Cmax, AUC0-8, and AUC0-inf on Day 5 with venetoclax in Cycle 2., Phase II, Part A and B: Cmax, Cmin, Tmax, T1/2, and other secondary PK parameters.

Source: https://euclinicaltrials.eu/ctis-public/view/2024-516294-78-00